EU clinical trial 2024-514456-32-00: A single-dose, randomized, two-period, two-sequence, crossover comparative bioavailability study on formulations containing ramipril, amlodipine and indapamide in combination product versus Triatec® 10 mg capsules (Sanofi - Produtos Farmacêuticos, Lda., Portugal), containing ramipril, Norvasc® 10 mg, tablets (Upjohn EESV, the Netherlands), containing amlodipine and Natrilix® 2.5 mg film-coated tablets (Les Laboratoires Servier, France), containing indapamide co-administered together as reference in healthy male and female volunteers under fasting conditions.
Sponsor: Zaklady Farmaceutyczne Polpharma S.A. (Pharmaceutical company). Phase: Human Pharmacology (Phase I)- Bioequivalence Study. Countries: Czechia (ended).
Therapeutic area(s): Diseases [C] - Cardiovascular Diseases [C14]
Gender: Female, Male. Age: 18-64 years. Enrolment: 72.
Status: Ended. Start date (EU): 2024-09-09. End date (EU): 2024-10-22. Decision date: 2024-07-30. Results received: No. Last updated: 2024-07-30.

Condition(s): hypertension

Source: https://euclinicaltrials.eu/ctis-public/view/2024-514456-32-00